EU clinical trial 2024-510789-17-00: Perioperative oral analgesia versus intravenous analgesia for knee arthroscopy, a randomized, double-blinded, non-inferiority trial. OVIKA-trial - S68618
Protocol code: OVIKA-trial S68618
Sponsor: UZ Leuven (Hospital/Clinic/Other health care facility). Phase: Therapeutic use (Phase IV). Countries: Belgium (ended).
Therapeutic area(s): Analytical, Diagnostic and Therapeutic Techniques and Equipment [E] - Anesthesia and Analgesia [E03]
Gender: Female, Male. Age: 18-64 years, 65+ years. Enrolment: 108.
Status: Ended. Start date (EU): 2024-09-03. End date (EU): 2026-01-15. Decision date: 2024-06-03. Results received: No. Last updated: 2024-06-03.

Condition(s): Postoperative pain relief after knee arthroscopy
Product: Natriumchlorid 0,9 % w/v Viaflo, Infusionslösung, PARACETAMOL, NaCl 0,9 % B. Braun, solution pour perfusion, IBUPROFEN, tablet, PARACETAMOL, IBUPROFEN

Primary endpoint: The primary endpoint will be the mean postoperative pain scores measured with the Numeric Rating Scale (NRS) during for minor knee arthroscopy, measured once preoperatively and at different time points postoperatively up to discharge
Endpoint(s): Key-secondary: - The need (number of patients) for postoperative rescue medication (morphine or clonidine) and time to readiness for discharge, Timepoint-specific NRS for pain during the hospital stay, NRS for pain 4h after discharge, NRS for pain 24h after discharge, Mean dose of opioid rescue medication (mean calculated per patient), Presence of Post-Operative Nausea and Vomiting (PONV) (at least once), Number of times emetics were used after discharge until 24 hours postop, Analgesic use during the first 24 hours, Economic evaluation, Quality of Recovery-40 questionnaire

Source: https://euclinicaltrials.eu/ctis-public/view/2024-510789-17-00